EU clinical trial 2024-520154-38-00: A Phase 3 Randomized, Double-blind, Placebo-controlled, Study of Bleximenib, Venetoclax and Azacitidine for the Treatment of Participants with Newly Diagnosed Acute Myeloid Leukemia Harboring KMT2ARearrangements or NPM1Mutations who are Ineligible for Intensive Chemotherapy
Protocol code: 75276617AML3001
Sponsor: Janssen Cilag International (Pharmaceutical company). Phase: Therapeutic confirmatory (Phase III). Countries: France (ongoing, recruiting), Greece (ongoing, recruiting), Portugal (ongoing, recruiting), Poland (ongoing, recruiting), Belgium (ongoing, recruiting), Denmark (ongoing, recruiting), Hungary (authorised, recruitment pending), Italy (ongoing, recruiting), Czechia (ongoing, recruiting), Spain (ongoing, recruiting), Austria (ongoing, recruiting), Germany (ongoing, recruiting).
Therapeutic area(s): Diseases [C] - Neoplasms [C04]
Gender: Female, Male. Age: 18-64 years, 65+ years. Enrolment: 246.
Start date (EU): 2025-07-29. Decision date: 2025-07-11. Results received: No. Last updated: 2026-05-21.
Decision dates by country: ES: 2025-07-16, BE: 2025-07-17, DE: 2025-07-17, FR: 2025-07-11, CZ: 2025-07-17, PT: 2025-07-17, GR: 2025-07-17, PL: 2025-07-18, HU: 2026-05-21, DK: 2025-07-21, AT: 2025-07-22, IT: 2025-07-17

Condition(s): Acute Myeloid Luekemia
Product: JNJ-75276617, Venclyxto 100 mg film-coated tablets, matching the 100 mg (G030), matching the 30 mg (G031), Venclyxto 100 mg film-coated tablets, Venclyxto 50 mg film-coated tablets, JNJ-75276617, JNJ-75276617, matching the 50 mg (G029), JNJ-75276617, Azacitidine betapharm 25 mg/mL powder for suspension for injection

Primary endpoint: Dual primary endpoints: CR and OS

Source: https://euclinicaltrials.eu/ctis-public/view/2024-520154-38-00